EU clinical trial 2024-514130-20-00: A Phase 3, Randomized, Placebo-Controlled, Double-Blinded, Multicenter Study to Evaluate the Efficacy and Safety of Pegcetacoplan in Patients with C3 Glomerulopathy or Immune-Complex Membranoproliferative Glomerulonephritis
Protocol code: APL2-C3G-310
Sponsor: Apellis Pharmaceuticals Inc. (Pharmaceutical company). Phase: Therapeutic confirmatory (Phase III). Countries: Austria (ended), Netherlands (ended), Italy (ended), Germany (ended).
Therapeutic area(s): Diseases [C] - Immune System Diseases [C20]
Gender: Female, Male. Age: 0-17 years, 18-64 years, 65+ years. Enrolment: 19.
Status: Ended. Start date (EU): 2022-04-04. End date (EU): 2024-12-09. End date: 2025-01-14. Decision date: 2024-11-08. Results received: Yes. Last updated: 2024-11-26.
Decision dates by country: AT: 2024-11-12, DE: 2024-11-08, IT: 2024-11-26, NL: 2024-11-11

Condition(s): complement 3 glomerulopathy (C3G)/immune complex membranoproliferative glomerulonephritis (IC-MPGN)
Product: Placebo for ASPAVELI 1 080 mg solution for infusion, ASPAVELI 1 080 mg solution for infusion

Primary endpoint: The primary efficacy endpoint is the log-transformed ratio of uPCR at week 26 compared to baseline.
Endpoint(s): The proportion of participants who meet the criteria for achieving a composite renal endpoint (a stable or improved eGFR compared to the baseline visit (≤15% reduction in eGFR), and a ≥50% reduction in uPCR compared to the baseline visit.), The proportion of participants with a reduction of at least 50% from baseline in uPCR, For participants with evaluable renal biopsies, the change from baseline in the activity score of the C3G histologic index score (Bomback et al. 2018), The proportion of participants with evaluable renal biopsies showing decreases in C3c staining on renal biopsy from baseline, hange from baseline in eGFR, The proportion of participants achieving proteinuria <1 g/day, For participants with serum albumin levels below the LLN at baseline, the proportion of participants with normalization of serum albumin levels, For participants with serum C3 levels below the LLN at baseline, the proportion of participants with serum C3 levels above the LLN, The change from baseline in the FACIT-Fatigue Scale score, The change from baseline in the KDQOL score

Source: https://euclinicaltrials.eu/ctis-public/view/2024-514130-20-00